EU clinical trial 2023-505941-21-00: Effekten av intrathekalt morfin eller intravenöst lidokain på postoperativ återhämtning efter robotassisterad övre urologisk kirurgi. Randomiserad assessor-blindad multicenterstudie.
Protocol code: 01
Sponsor: Region Oestergoetland (Hospital/Clinic/Other health care facility). Phase: Therapeutic confirmatory (Phase III). Countries: Sweden (ongoing, recruiting).
Therapeutic area(s): Diseases [C] - Neoplasms [C04]; Diseases [C] - Female Urogenital Diseases and Pregnancy Complications [C13]; Diseases [C] - Male Urogenital Diseases [C12]
Gender: Female, Male. Age: 18-64 years, 65+ years. Enrolment: 220.
Status: Ongoing, recruiting. Start date (EU): 2024-04-09. Decision date: 2023-10-27. Results received: No. Last updated: 2026-07-30.

Condition(s): Renal or ureter malignancy; Renal or ureter benign tumor; Nephrolithiasis; Renal reflux
Product: MORPHINE, LIDOCAINE, BUPIVACAINE

Primary endpoint: QoR-15 score at postoperative day 1
Endpoint(s): QoR-15 score preoperatively, QoR-15 score at postoperative day 2, pain (NRS) in rest and during motion 2hrs after arrival to the PACU/ICU/HDU, pain (NRS) on POD 1-3, pain (NRS) in rest and during motion at POD 7, Time from arrival in the OR to start of surgery, Time from end of surgery until leaving the OR, Incidence of unplanned termination of the lidocaine infusion, Amount of remifentanil in patients given remifentanil, amount of intraoperative opiods in patients not receiving remifentantil, length of stay at the PACU/ICU/HDU, amount of opioids administered at the PACU/ICU/HDU during the first 24 hrs from the end of surgery, PONV requiring treatment at 0-6hrs and 6-24 hrs postoperatively as well as during the whole postoperative stay, "Time out-of-bed" on POD 1-3, Amount of opioids administered during the first 24 hrs after end of surgery at the PACU/ICU/HDU and ward, First POD passing gases, First POD passing stool, incidence of pruritus, Length of stay and DAOH30, Postoperative complications untill POD 30, Requirement for opioids after discharge, Incidence of respiratory depression leading to the use of a mu-antagonist within 48 hrs of induction of anesthesia, Intraoperative fluid balance, Time with low blood pressure during anesthesia, Lowest MAP within 10 minutes after induction of anesthesia, Highest MAP within 10 minutes of start of abdominal insufflation, Fraction of patients needing norepinephrine before start of surgery 15 minutes after start of insufflation, Fraction of patients needing norepinephrine intraoperatively (later than 15 minutes after start of insufflation), Average infusion rate of norepinephrine, in patients receiving norepinephrine, before 15 minutes after start of insufflation, Average infusion rate of norepinephrine, in patients receiving norepinephrine, after 15 minutes after start of insufflation, Intraoperative Cardiac Index, Intraoperative Stroke Volume Index, Intraoperative Cardiac Power Index and dPmx, Intraoperative Pulse Pressure Variation and Stroke Volume Variation, Intraoperative Systemic Vascular Resistance Index, Intraoperative heart rate, biochemical markers of inflammation, Construct validity, reliability and feasibility of a Swedish translation of QoR-PACU

Source: https://euclinicaltrials.eu/ctis-public/view/2023-505941-21-00